EU clinical trial 2023-510353-42-00: A Randomized, Placebo-Controlled, Multiple Ascending Dose Study Assessing Safety, Tolerability, Pharmacodynamics, Efficacy, and Pharmacokinetics of DYNE-101 Administered to Participants with Myotonic Dystrophy Type 1
Sponsor: Dyne Therapeutics Inc. (Pharmaceutical company). Phase: Phase I and Phase II (Integrated)- First administration to humans. Countries: Netherlands (ongoing, recruitment ended), France (ongoing, recruitment ended), Italy (ongoing, recruitment ended), Germany (ongoing, recruitment ended).
Therapeutic area(s): Diseases [C] - Musculoskeletal Diseases [C05]; Diseases [C] - Nervous System Diseases [C10]
Gender: Female, Male. Age: 18-64 years. Enrolment: 103.
Status: Ongoing, recruitment ended. Start date (EU): 2022-02-21. Decision date: 2024-04-22. Results received: No. Last updated: 2026-05-08.
Decision dates by country: FR: 2024-04-29, NL: 2024-04-22, IT: 2024-04-30, DE: 2024-04-29

Condition(s): Myotonic Dystrophy Type 1
Product: DYNE-101, The placebo is commercially available 0.9% (w/v) saline solution intended for IV

Primary endpoint: Treatment-emergent adverse events (TEAEs), treatment-emergent serious adverse events (TESAEs), TEAEs considered related to study drug, and TEAEs leading to discontinuation from study drug and discontinuation from the study., Dose Expansion Cohort: Change from baseline in myotonia as measured by vHOT (middle finger) at Week 25
Endpoint(s): Change from baseline in CASI in skeletal muscle tissue Change from baseline in DMPK RNA expression in muscle tissue, MAD Cohorts Change from baseline in hand grip relaxation time by a dynamometer Change from baseline in myotonia as measured by vHOT Change from baseline in Quantitative Myometry Testing (QMT) Change from baseline in 10-meter walk/run test (10-MWRT) Change from baseline in stair-ascend/descend test Change from baseline in 5 times sit to stand (5×STS) Change from baseline in 9-Hole Peg Test (9-HPT), Dose Expansion Cohort Change from baseline in CASI in skeletal muscle tissue at Week 25 Change from baseline in 10-MWRT at Week 25 Change from baseline in 5×STS at Week 25 Change from baseline in MDHI total score at Week 25 Change from baseline in 9-HPT at Week 25 Change from baseline in percent predicted hand grip strength at Week 25, MAD Cohorts Plasma endpoints: Max observed plasma drug concentration Time to max observed plasma drug concentration Area under the plasma-drug concentration-time curve from time 0 to the last quantifiable concentration AUC extrapolated to time infinity Apparent terminal phase elimination rate constant and elimination half-life Plasma clearance Volume of distribution at the terminal phase, if appropriate and at steady state, if appropriate Muscle tissue endpoint: Tissue ASO concentration, MAD Cohorts Incidence of antidrug antibodies (ADAs)

Source: https://euclinicaltrials.eu/ctis-public/view/2023-510353-42-00